EU clinical trial 2024-517183-31-00: Neoadjuvant Chemotherapy followed by Pre-operative Chemoradiation and Consolidation Chemotherapy before Surgery in High Risk Rectal Cancer: Multicentric Phase II Study
Sponsor: Centro Di Riferimento Oncologico Di Aviano (Hospital/Clinic/Other health care facility). Phase: Therapeutic exploratory (Phase II). Countries: Italy (ended).
Therapeutic area(s): Diseases [C] - Neoplasms [C04]
Gender: Female, Male. Age: 18-64 years, 65+ years. Enrolment: 93.
Status: Ended. Start date (EU): 2022-11-18. End date (EU): 2025-09-08. Decision date: 2024-09-30. Results received: No. Last updated: 2024-09-30.

Condition(s): High Risk Rectal Cancer
Product: CAPECITABINE, OXALIPLATIN

Primary endpoint: Pathological Complete Remissions (pCR)

Source: https://euclinicaltrials.eu/ctis-public/view/2024-517183-31-00